EU clinical trial 2023-504582-22-00: A study to test how either a capsule or a tablet with NDec (Decitabine and Tetrahydrouridine) works in the body of healthy people
Protocol code: NN7533-7587
Sponsor: Novo Nordisk A/S (Pharmaceutical company). Phase: Human Pharmacology (Phase I)- First administration to humans. Countries: Germany (not authorised).
Therapeutic area(s): Diseases [C] - Hemic and Lymphatic Diseases [C15]
Gender: Female, Male. Age: 18-64 years. Enrolment: 48.
Status: Not authorised. Decision date: 2023-10-17. Results received: No. Last updated: 2023-10-17.

Condition(s): Sickle Cell Disease

Source: https://euclinicaltrials.eu/ctis-public/view/2023-504582-22-00